EU clinical trial 2023-506250-20-00: A RANDOMIZED, DOUBLE-BLIND, PLACEBO-CONTROLLED, MULTICENTER, ADAPTIVE PHASE III TRIAL TO INVESTIGATE EFFICACY AND SAFETY OF VILOBELIMAB IN THE TREATMENT OF ULCERATIVE PYODERMA GANGRENOSUM
Protocol code: IFX-1-P3.4
Sponsor: InflaRx GmbH (Pharmaceutical company). Phase: Therapeutic confirmatory (Phase III). Countries: Belgium (ended), Hungary (ended), Poland (ended), Netherlands (ended), France (ended), Spain (ended), Germany (ended), Italy (ended).
Therapeutic area(s): Diseases [C] - Skin and Connective Tissue Diseases [C17]
Gender: Female, Male. Age: 18-64 years, 65+ years. Enrolment: 101.
Status: Ended. Start date (EU): 2023-12-11. End date (EU): 2025-05-27. Decision date: 2023-12-04. Results received: Yes. Last updated: 2025-05-22.
Decision dates by country: NL: 2023-12-05, HU: 2023-12-04, IT: 2023-12-11, ES: 2023-12-11, DE: 2023-12-07, PL: 2023-12-06, BE: 2023-12-05, FR: 2023-12-08

Condition(s): ulcerative pyoderma gangrenosum
Product: PREDNISOLONE, CORTISONE ACETATE, FLUDROCORTISONE, Gohibic, TRIAMCINOLONE, PREDNISONE, DEXAMETHASONE, HYDROCORTISONE, METHYLPREDNISOLONE, IFX-1 placebo is formulated as PBS (150 mM sodium chloride, 10 mM sodium phosphate, pH 7.0) with 0.05% polysorbate 80. IFX-1 placebo is diluted in sterile 0.9% sodium chloride to the required concentration and volume. This diluent is a commercial product not accompanying IFX-1 placebo., BETAMETHASONE

Primary endpoint: Proportion of patients achieving complete closure of the target ulcer up to and including EOT visit; where complete closure of the target ulcer is assessed by the investigator as complete re-epithelization (defined as wound covered by epithelial skin layer or scar) without drainage or dressing requirements confirmed at two consecutive study visits 2 weeks apart.
Endpoint(s): Proportion of patients achieving disease remission up to and including EOT visit; where disease remission is assessed by the investigator as complete re-epithelization (defined as wound covered by epithelial skin layer or scar) of all PG ulcers, without drainage or dressing requirements confirmed at two consecutive study visits 2 weeks apart., Proportion of patients achieving a pain reduction related to the target ulcer of at least 3 points compared to baseline or reaching 0, at any time between Week 10 and EOT visit inclusively (measured by the 0-10 numeric rating scale (NRS))., Proportion of patients achieving a target ulcer volume reduction of 50% or more compared to baseline, at End of Treatment visit, assessed by the investigator and supported by standardized photographic documentation, Proportion of patients achieving a pain reduction related to the target ulcer of at least 2 points compared to baseline or reaching 0, at any time between Week 10 and EOT visit inclusively (measured by the 0-10 NRS)., Maximum absolute decrease in target ulcer pain from baseline at any time up to and including EOT visit (assessed by patients on the 0-10 NRS), Absolute change in target ulcer pain from baseline at Week 10, 18, and 26 (assessed by patients on the 0-10 NRS), Maximum reduction of the target ulcer volume by EOT visit compared to baseline., Time to first detected complete closure of the target ulcer; where complete closure of target ulcer is assessed by the investigator as complete re-epithelization (defined as wound covered by epithelial skin layer or scar) without drainage or dressing requirements., Proportion of patients with Patient-Level Stopping Criteria (PLSC) or rescue therapy, Time to early stop of study medication due to PLSC or due to opting for rescue therapy, Clinician’s Global Impression of Change (CGI-C) from baseline at EOT visit based on a 7-point scale, Proportion of patients achieving Physician’s Global Assessment (PGA) score ≤ 1 of the target ulcer up to and including EOT visit., Proportion of patients achieving PGA ≤ 3 of the target ulcer up to and including EOT visit

Source: https://euclinicaltrials.eu/ctis-public/view/2023-506250-20-00